EU clinical trial 2024-510884-51-00: Tezepelumab (Anti-TSLP-mab) in progressive pulmonary fibrosis interstitial lung disease with evidence of eosinophilia - A prospective two-armed, phase II clinical multicentre randomized, placebo-controlled (2:1), blinded with open-label extension trial (TEFIBEOS)
Protocol code: KKS-307
Sponsor: Philipps-Universitaet Marburg (Educational Institution). Phase: Therapeutic exploratory (Phase II). Countries: Germany (temporarily halted).
Therapeutic area(s): Diseases [C] - Respiratory Tract Diseases [C08]
Gender: Female, Male. Age: 18-64 years, 65+ years. Enrolment: 39.
Status: Temporarily halted. Start date (EU): 2025-06-09. Decision date: 2024-09-25. Results received: No. Last updated: 2026-05-29.

Condition(s): Progressive pulmonary fibrosis interstitial lung disease with evidence of eosinophilia
Product: Tezspire 210 mg solution for injection in pre-filled syringe, TEZEPELUMAB, 0.7% (w/v) sodium carboxy methyl cellulose, 10 mM acetate, 250 mM L-proline, 0.01% (w/v) polysorbate 80, pH 5.0

Primary endpoint: Change in blood cell count (absolute numbers) after 24 weeks Primary outcome measure: Change in number of eosinophils in differential blood cell count (absolute numbers) between baseline and 24 weeks of treatment compared to placebo.
Endpoint(s): change from baseline in forced vital capacity (FVC), Change from baseline in King’s Brief Interstitial Lung Disease Questionnaire (K-BILD) or Quality of life in patients with idiopathic pulmonary fibrosis (QPF) Questionnaire at 20 weeks, Time to decrease of FVC > 5% from baseline, Time to decrease of DLCO > 10% from baseline, Time to first acute exacerbation of underlying interstitial lung disease, Time to first all-cause hospitalization, Time to all-cause mortality, Time to composite endpoint of disease progression (defined as decline of FVC ≥ 5% or DLCOcSB ≥ 10% from baseline or death from any cause), Change from baseline in total lung capacity (TLC), Change from baseline in DLCOcSB, Change from baseline in DLCOc/VA, Change from baseline in capillary pO2, Change form baseline in 6-minute walking test distance, Change from baseline in Quality of life in patients with idiopathic pulmonary fibrosis (QPF) Questionnaire score. Key outcome measure: difference placebo vs week 24., Need to increase corticosteroid dose, Need to increase dose of disease-modifying antirheumatic drugs, Need to initiate new disease-modifying antiheumatic drugs

Source: https://euclinicaltrials.eu/ctis-public/view/2024-510884-51-00